EU clinical trial 2025-523558-14-00: A Phase 1 Study of AIR-001 in Adults with AATD.
Protocol code: AIR-001-AATD-101
Sponsor: Airna Corp. (Pharmaceutical company). Phase: Human Pharmacology (Phase I)- First administration to humans. Countries: Sweden (authorised, recruitment pending), Ireland (authorised, recruitment pending), Spain (authorised, recruitment pending), Netherlands (authorised, recruitment pending), Portugal (authorised, recruitment pending), Germany (authorised, recruitment pending).
Therapeutic area(s): Diseases [C] - Respiratory Tract Diseases [C08]; Diseases [C] - Congenital, Hereditary, and Neonatal Diseases and Abnormalities [C16]; Diseases [C] - Digestive System Diseases [C06]
Gender: Female, Male. Age: 18-64 years, 65+ years. Enrolment: 19.
Status: Authorised, recruitment pending. Decision date: 2026-04-17. Results received: No. Last updated: 2026-07-20.
Decision dates by country: SE: 2026-04-17, NL: 2026-04-23, ES: 2026-04-24, DE: 2026-04-21, PT: 2026-04-17, IE: 2026-04-24

Condition(s): Alpha-1 Antitrypsin Deficiency

Source: https://euclinicaltrials.eu/ctis-public/view/2025-523558-14-00